EU clinical trial 2024-519921-39-00: Effect of cladribine treatment on microglial activation in the CNS
Sponsor: Varsinais-Suomen hyvinvointialue (Hospital/Clinic/Other health care facility). Phase: Therapeutic use (Phase IV). Countries: Finland (ongoing, recruitment ended).
Therapeutic area(s): Diseases [C] - Immune System Diseases [C20]; Diseases [C] - Nervous System Diseases [C10]
Gender: Female, Male. Age: 18-64 years. Enrolment: 15.
Status: Ongoing, recruitment ended. Start date (EU): 2019-08-16. Decision date: 2024-12-19. Results received: No. Last updated: 2025-02-12.

Condition(s): Multiple Sclerosis
Product: MAVENCLAD 10 mg tablets

Primary endpoint: Change in microglial cell activation in different brain areas (NAWM normal appearing grey matter and the chronic active/ smoldering (slowly expanding) lesions) before and after 18 months of treatment with cladribine evaluated with [11C]PK11195-PET-imaging.
Endpoint(s): Change in microglial cell activation in different brain areas (normal appearing white matter (NAWM), normal appearing grey matter (NAGM) and the chronic active/ smoldering lesions) before and after 18 months of treatment with cladribine evaluated with QSM-MRI., Change in the total lesion load of the white matter MS plaques at different time points using MRI, Change in total brain, white matter (WM) and gray matter (GM) volumes using MRI at different time points of the study, Change in MD (mean diffusivity) and FA (fractional anisotropy) using DTI (diffusion tensor imaging at different time points of the study, Correlation of the baseline microglial activation status to the clinical outcome parameters at the end of the study (18 months) to evaluate whether high microglial activation is predictive of higher likelihood of progression and other measures of disability., Correlation of the baseline microglial activation status to the MRI parameters, Different microglial activation at baseline in the study group when compared to microglial activation in a group of age-matched previously imaged healthy controls, Different microglial activation in the study group to microglial activation in an independent group of previously imaged age-matched untreated MS-patients.

Source: https://euclinicaltrials.eu/ctis-public/view/2024-519921-39-00